EU clinical trial 2024-512707-40-00: A Phase 2, Multicenter, Randomized, Double-Blind, Placebo-Controlled Study to Evaluate the Efficacy and Safety of Obexelimab in Patients with Relapsing Multiple Sclerosis
Protocol code: ZB012-02-002
Sponsor: Zenas Biopharma (USA) LLC (Pharmaceutical company). Phase: Therapeutic exploratory (Phase II). Countries: Greece (ongoing, recruitment ended), Finland (ended), Italy (ongoing, recruitment ended), Czechia (ongoing, recruitment ended), Denmark (ongoing, recruitment ended), Austria (ongoing, recruitment ended), Croatia (ongoing, recruitment ended), Spain (ongoing, recruitment ended), Belgium (ongoing, recruitment ended), Poland (ongoing, recruitment ended).
Therapeutic area(s): Diseases [C] - Nervous System Diseases [C10]
Gender: Female, Male. Age: 18-64 years. Enrolment: 93.
Start date (EU): 2024-11-07. Decision date: 2024-09-27. Results received: No. Last updated: 2026-06-18.
Decision dates by country: FI: 2024-10-01, BE: 2024-09-30, ES: 2024-09-27, IT: 2024-10-01, AT: 2024-10-02, HR: 2024-10-01, CZ: 2024-10-01, GR: 2024-10-01, PL: 2024-09-30, DK: 2024-09-30

Condition(s): RELAPSING MULTIPLE SCLEROSIS
Product: Placebo sterile solution for SC injection, Obexelimab

Primary endpoint: Cumulative number of new GdE T1 hyperintense lesions over Week 8 and Week 12, as measured by brain MRI
Endpoint(s): Cumulative number of new and/or enlarging T2 weighted hyperintense lesions detected over Week 8 and Week 12, Number of new GdE T1 hyperintense lesions at Week 4, Week 8, and Week 12, Change from baseline in volume of T2 lesions at Week 12, Change from baseline in serum NfL at Week 12, Incidence of adverse events (AEs), serious adverse events (SAEs), and AEs of special interest, (AESI), as defined by the Common Terminology of Criteria for Adverse Events (CTCAE) Version 5.0

Source: https://euclinicaltrials.eu/ctis-public/view/2024-512707-40-00